EU clinical trial 2023-510124-77-01: Safety and Feasibility of Irradiation and Nivolumab in Esophageal Cancer Cohorts – (INEC study) – A Phase I/II trial (CA209-9M9 study)
Protocol code: CA209-9M9-03
Sponsor: Oslo University Hospital HF (Hospital/Clinic/Other health care facility). Phase: Phase I and Phase II (Integrated)- Other. Countries: Norway (ongoing, recruitment ended).
Therapeutic area(s): Diseases [C] - Pathological Conditions, Signs and Symptoms [C23]
Gender: Female, Male. Age: 18-64 years, 65+ years. Enrolment: 30.
Status: Ongoing, recruitment ended. Start date (EU): 2024-09-28. Decision date: 2024-09-27. Results received: No. Last updated: 2025-12-19.

Condition(s): Eosophageal cancer
Product: OPDIVO 10 mg/mL concentrate for solution for infusion., OPDIVO 10 mg/mL concentrate for solution for infusion., OPDIVO 10 mg/mL concentrate for solution for infusion.

Primary endpoint: Safety: The primary end point in this study is safety measurements done to determine the safety profile of the treatment; safety parameters included adverse events, biochemistry, hematology, vital signs and performance status. Adverse events are recorded according to CTCAE v5.0 (CTCAE grade 2-5 rate)., Feasibility: The feasibility of conducting the study will be reported as number of patients screened, and number of patients successfully included into the study per one year of accrual time.
Endpoint(s): Overall Survival: The time from onset of treatment (day 1) to death from any cause., Infield and Outfield Response to Treatment: The response rate as measured by RECIST 1.1 and immune-related RECIST (ir-RECIST) within the irradiated volume (infield) verses outside the irradiated volume (outfield)., Progression Free Survival (Only Cohort B): The time from treatment start (day -21) until the disease progresses (PD) as determined by investigators from tumor assessments per RECIST or death from any cause., Disease Free Survival (Only Cohort C): The time from surgery until recurrency or occurrence of disease progression as determined by investigators from tumor assessments per RECIST., Pathology Complete Response Rate (Only Cohort C): The complete response rate in the surgical specimen by Chirieac grading by pathologist., Quality of Life:Quality of Life Questionnaires (QLQ) by patient reported outcomes EORTC QLQ-C30, EORTC QLQ-OG25 and EQ-5D.

Source: https://euclinicaltrials.eu/ctis-public/view/2023-510124-77-01